EU clinical trial 2024-518434-83-01: Effect of Tofacitinib on coagulation and platelet function, and its role in thromboembolic events
Protocol code: GIS-2021-JAKihemo
Sponsor: Fundacion Para La Investigacion Biomedica Del Hospital Universitario La Princesa (Laboratory/Research/Testing facility). Phase: Therapeutic use (Phase IV). Countries: Spain (ended).
Therapeutic area(s): Diseases [C] - Digestive System Diseases [C06]
Gender: Female, Male. Age: 18-64 years, 65+ years. Enrolment: 60.
Status: Ended. Start date (EU): 2022-06-01. End date (EU): 2026-06-11. Decision date: 2024-11-20. Results received: No. Last updated: 2026-03-05.

Condition(s): ulcerative colitis
Product: INFLIXIMAB, ADALIMUMAB, TOFACITINIB, GOLIMUMAB

Primary endpoint: Platelet activation status will be assessed ex vivo in platelet-rich plasma (PRP) samples from UC patients (active and quiescent) and healthy controls incubated in the absence or presence of drug (tofacitinib or anti-TNFα). Regarding the in vivo study, platelet activation will be analyzed in samples from patients with active UC before and after initiating treatment with tofacitinib or anti-TNFα. It will be mesured by rate of platelet agregation
Endpoint(s): Endoscopic activity will be evaluated by the Mayo endoscopic sub-score; endoscopic activity will be considered as ≥ 2., Endoscopic response will be defined as a decrease of ≥ 1 point in the Mayo endoscopic sub-score 3 months after starting treatment., Endoscopic remission will be defined as an endoscopic subscore ≤1, 3 months after starting treatment.

Source: https://euclinicaltrials.eu/ctis-public/view/2024-518434-83-01